EU clinical trial 2024-518554-17-00: A GLP-1 receptor PET imaging add-on study within the VERA-T1D trial investigating the effects on beta cell mass (Image-VER-A-T1D)
Sponsor: Radboud universitair medisch centrum Stichting (Hospital/Clinic/Other health care facility). Phase: Therapeutic exploratory (Phase II). Countries: Austria (authorised, recruitment pending), France (authorised, recruitment pending).
Therapeutic area(s): Diseases [C] - Nutritional and Metabolic Diseases [C18]
Gender: Female, Male. Age: 18-64 years, 65+ years. Enrolment: 20.
Status: Authorised, recruitment pending. Decision date: 2025-01-30. Results received: No. Last updated: 2025-04-14.
Decision dates by country: AT: 2025-01-30, FR: 2025-01-30

Condition(s): type 1 diabetes mellitus
Product: EXENATIDE, VERAPAMIL

Primary endpoint: The total pancreatic uptake of 68Ga-NODAGA-exendin for determination of beta cell mass at the point of inclusion and after 12 months.
Endpoint(s): Changes in 68Ga-NODAGA-exendin pancreas uptake in realtion to changes in C-peptide measurements., Changes in 68Ga-NODAGA-exendin pancreas uptake in relation to changes in proinsulin/preproinsulin measurements., Differences in 68Ga-NODAGA-exendin uptake between individuals and between the two timepoints of imaging intra-individually

Source: https://euclinicaltrials.eu/ctis-public/view/2024-518554-17-00